EU clinical trial 2023-503850-11-00: A multicenter, randomized, double-blind, placebo-controlled trial to assess the efficacy and safety of a post-coital intravaginal gel of PKB171 in couples with mild male factor infertility.
Protocol code: PRO001
Sponsor: Prokrea Bcn S.L. (Pharmaceutical company). Phase: Phase II and Phase III (Integrated). Countries: Spain (ongoing, recruiting).
Therapeutic area(s): Phenomena and Processes [G] - Reproductive and Urinary Physiological Phenomena [G08]
Gender: Female, Male. Age: 18-64 years. Enrolment: 732.
Status: Ongoing, recruiting. Start date (EU): 2025-10-28. Decision date: 2025-08-20. Results received: No. Last updated: 2026-03-06.
Decision dates by country: ES: 2025-10-09

Condition(s): Oligospermia and/or asthenozoospermia
Product: Gel PKB171, Placebo gel XXX

Primary endpoint: Rate of clinical pregnancies defined as intrauterine pregnancy with confirmed fetal heartbeat by the 6-8th week of gestation.
Endpoint(s): Rate of Biochemical pregnancy: positive pregnancy test (blood β-hCG), Rate of Pregnancy loss: nonviable intrauterine pregnancy up to 20 weeks gestation, Ongoing pregnancy: positive heartbeat at ultrasound after 20 weeks of gestation, Gestational age at delivery, Mode of delivery (vaginal delivery / C-section), Incidence of obstetric complications: preterm birth; preeclampsia; placenta previa; small-for-gestational age or growth restriction; large-for-gestational age, Fetal anomalies: any fetal anomaly (altered system and description of the anomaly), diagnostic of chromosomal or genetic abnormalities (yes/no; if yes, details of the anomaly), Live birth (yes/no), Local tolerance., Adverse events., Safety laboratory., Vital signs.

Source: https://euclinicaltrials.eu/ctis-public/view/2023-503850-11-00